EU clinical trial 2023-503990-39-00: SERENA-6: A Phase III, Double-blind, Randomised Study to Assess Switching to AZD9833 (a Next Generation, Oral SERD) + CDK4/6 Inhibitor vs Continuing Aromatase Inhibitor (Letrozole or Anastrozole) + CDK4/6 Inhibitor in HR+/HER2- MBC Patients with Detectable ESR1 Mutation Without Disease Progression During 1L Treatment with Aromatase Inhibitor + CDK4/6 Inhibitor A ctDNA Guided Early Switch Study
Protocol code: D8534C00001
Sponsor: AstraZeneca AB (Pharmaceutical company). Phase: Therapeutic confirmatory (Phase III). Countries: Slovakia (ongoing, recruitment ended), France (ongoing, recruitment ended), Bulgaria (ongoing, recruitment ended), Poland (ongoing, recruitment ended), Italy (ongoing, recruitment ended), Norway (ended), Germany (ongoing, recruitment ended), Hungary (ongoing, recruitment ended), Belgium (ongoing, recruitment ended), Spain (ongoing, recruitment ended), Austria (ongoing, recruitment ended), Portugal (ongoing, recruitment ended).
Therapeutic area(s): Diseases [C] - Neoplasms [C04]
Gender: Female, Male. Age: 18-64 years, 65+ years. Enrolment: 128.
Start date (EU): 2021-09-30. Decision date: 2024-09-10. Results received: No. Last updated: 2026-04-27.
Decision dates by country: BE: 2024-09-10, FR: 2024-09-16, IT: 2024-09-16, NO: 2024-09-10, PL: 2024-09-11, AT: 2024-10-14, DE: 2024-09-12, HU: 2024-09-10, BG: 2024-09-13, ES: 2024-09-12, SK: 2024-09-10, PT: 2024-10-03

Condition(s): Estrogen Receptor-Positive, HER-2 negative Advanced Breast Cancer
Product: IBRANCE 75 mg film-coated tablets, GOSERELIN ACETATE, Placebo to match camizestrant, Placebo to match anastrozole, camizestrant, ABEMACICLIB, Placebo to match letrozole, IBRANCE 100 mg film-coated tablets, Arimidex® 1 mg Filmtabletten, IBRANCE 125 mg film-coated tablets, RIBOCICLIB, LETROZOLE, LEUPRORELIN ACETATE, ABEMACICLIB, Camizestrant, ABEMACICLIB

Primary endpoint: Progression-free survival (PFS) is defined as the time from randomisation until progression per RECIST 1.1 as assessed by the investigator at the local site, or death due to any cause.
Endpoint(s): Overall survival (OS), Progression-free survival 2 (PFS2), Objective response rate (ORR) assessed by the Investigator as defined by RECIST version 1.1, Chemotherapy-free survival, Clinical benefit rate at 24 weeks (CBR24), Time to first subsequent anti-cancer therapy (TFST), Time to second subsequent therapy (TSST), Time to deterioration (TTD), Plasma concentration of AZD9833 at specified timepoints, Change from baseline in EORTC QLQ-C30 and EORTC QLQ-BR23 scale

Source: https://euclinicaltrials.eu/ctis-public/view/2023-503990-39-00